EU clinical trial 2024-511595-32-00: Erector Spinae Plane Block for acute low back pain: a prospective double-blind randomized multicenter study. ESP-BACK
Protocol code: RECHMPL23_0409
Sponsor: Centre Hospitalier Universitaire De Montpellier (Hospital/Clinic/Other health care facility). Phase: Therapeutic use (Phase IV). Countries: France (authorised, recruitment pending).
Therapeutic area(s): Analytical, Diagnostic and Therapeutic Techniques and Equipment [E] - Anesthesia and Analgesia [E03]
Gender: Female, Male. Age: 18-64 years, 65+ years. Enrolment: 300.
Status: Authorised, recruitment pending. Decision date: 2025-11-26. Results received: No. Last updated: 2025-11-26.

Condition(s): Acute low back pain
Product: KETOPROFEN, DEXAMETHASONE PHOSPHATE, ROPIVACAINE HYDROCHLORIDE, TRAMADOL HYDROCHLORIDE, KETOPROFEN, PARACETAMOL, SODIUM CHLORIDE, PARACETAMOL

Primary endpoint: Reduction of pain on mobilization (50 % decrease in pain intensity) 30 minutes after the procedure, Validation of the "Get Up and Go" test (completed in less than 20 seconds) 30 minutes after the procedure
Endpoint(s): Patient-reported VAS pain score from day 0 to month 6, Score of the Brief Pain Inventory (BPI) questionnaire on day 14, month 3, and month 6, Consumption of rescue analgesic (tramadol) from day 0 to month 6 (total number of tablets), Steps count from day 0 to day 3, Quality of sleep (sleep duration, sleep onset and awakeness numbers in hours) from day 0 to day 3, Score of EIFEL questionnaire on day 3, Score of WOMAC questionnaire on day 14, month 3, and month 6, Number of medical consultations for low back pain up to month 6, Number of physiotherapy sessions for low back pain up to month 6, Number of recurrences of low back pain up to month 6, Score of SF-12 questionnaire, at month 3 and month 6, Side effects related to rescue analgesics (such as nausea, vomiting…) up to month 6, Opioid misuse will be assessed with the score of POMI questionnaire on day 14, month 3, and month 6, Number of days from the procedure to the time returning to work up to month 6, The incremental cost-utility ratio (ICUR) at 6 months, based on costs collected in the study CRF and on utility values derived from the EQ-5D-5L questionnaire

Source: https://euclinicaltrials.eu/ctis-public/view/2024-511595-32-00